EU clinical trial 2025-521268-37-00: A randomized, double-blind, placebo-controlled study to evaluate the effect of dupilumab on airway inflammation through assessments of mucus plugging and other lung imaging parameters in patients with chronic obstructive pulmonary disease (AEOLUS)
Protocol code: LPS18583
Sponsor: Sanofi-Aventis Recherche & Developpement (Pharmaceutical company). Phase: Therapeutic use (Phase IV). Countries: Netherlands (ongoing, recruiting), Hungary (ongoing, recruiting), France (ongoing, recruiting), Germany (authorised, recruitment pending), Austria (authorised, recruitment pending), Spain (ongoing, recruiting), Poland (ongoing, recruiting), Sweden (authorised, recruitment pending), Italy (ongoing, recruiting), Denmark (ongoing, recruiting).
Therapeutic area(s): Diseases [C] - Respiratory Tract Diseases [C08]
Gender: Female, Male. Age: 18-64 years, 65+ years. Enrolment: 184.
Start date (EU): 2025-11-25. Decision date: 2025-09-29. Results received: No. Last updated: 2026-04-21.
Decision dates by country: AT: 2025-10-06, DK: 2025-09-30, FR: 2025-09-29, DE: 2025-09-30, HU: 2025-10-03, IT: 2025-10-01, ES: 2025-10-03, NL: 2025-10-06, PL: 2025-10-06, SE: 2025-09-30

Condition(s): Respiratory tract diseases
Product: Dupilumab, matched placebo for test product, Ventolin Evohaler 100 micrograms

Primary endpoint: Change from baseline to Week 24 in global lung mucus score (UCSF mucus scoring)
Endpoint(s): Change from baseline to Week 24 in mucus volume for global lung by High-resolution Computed Tomography (HRCT), Change from baseline to Week 24 in trimmed distal airway wall thickness at TLC by HRCT, Change from baseline to Week 24 in airway resistance from R5 to R20 measured by Forced Oscillation Technique (FOT), Change from baseline to Week 24 in Reactance area (AX) measured by FOT, Incidence of Treatment-Emergent Adverse Event (TEAE), Serious Adverse Event (SAE), and Adverse Event of Special Interest (AESI) including potentially clinically significant abnormalities

Source: https://euclinicaltrials.eu/ctis-public/view/2025-521268-37-00